EU clinical trial 2022-500727-68-01: Perineural injections of incobotulinumtoxin-A for diabetic neuropathic pain of the lower extremities: A double-blind, randomized, placebo-controlled study (PINBOT)
Sponsor: Rigshospitalet (Hospital/Clinic/Other health care facility). Phase: Therapeutic exploratory (Phase II). Countries: Denmark (ongoing, recruiting).
Therapeutic area(s): Diseases [C] - Nutritional and Metabolic Diseases [C18]; Diseases [C] - Nervous System Diseases [C10]
Gender: Female, Male. Age: 18-64 years, 65+ years. Enrolment: 80.
Status: Ongoing, recruiting. Start date (EU): 2023-08-07. Decision date: 2022-11-08. Results received: No. Last updated: 2026-02-25.

Condition(s): Diabetic neuropathic pain
Product: 5 ml of sterile saline 0,9% solution, mixed with trace amounts of human a, Xeomin, pulver til injektionsvæske, opløsning 100 enheder

Primary endpoint: Efficacy of pain relief of bilateral perineural injections of incobotulinumtoxin-A around the distal ischial nerve. The primary outcome will be tested using a generalised linear mixed model of repeated measures of daily (or weekly means) of pain scores (NRS), comparing active and placebo groups for 24 weeks, with the mean baseline pain score of each group as a covariate.
Endpoint(s): QST: Sensory profiles will be generated for each QST sample as stipulated by the DFNS protocol. Accordingly, recorded values will be z-transformed by subtracting the mean value of an age- and sex matched reference group. Z-scores of >1.96 or <−1.96 i.e., falling outside the 95% confidence interval for matched healthy controls, will be considered abnormal. Absolute scores will also be compared before and after treatment, and between the two groups., Muscle power: Muscle power of the lower extremities over time for active and placebo groups will be compared to baseline and between groups using a generalised linear mixed-model of repeated measures, with pre-treatment baseline values as a covariate., HR-QoL:EQ-5D-5L visual analogue scale of self-perceived health scores for active and placebo groups will be compared to baseline and between groups using a generalised linear mixed-model of repeated measures, with pre-treatment baseline values as a covariate., ADL: COPM scores for active and placebo groups will be compared to baseline and between groups using a generalised linear mixed-model of repeated measures, with pre-treatment baseline values as a covariate., Depression: BDI-II total- and subscores for active and placebo groups will be compared to baseline and between groups using a generalised linear mixed-model of repeated measures, with pre-treatment baseline values as a covariate., Physical activity: PAS-2-DK scores for active and placebo groups will be compared to baseline and between groups using a generalised linear mixed-model of repeated measures, with pre-treatment baseline values as a covariate., Rescue medication: Average days with use of rescue medication per week for active and placebo groups will be compared to baseline and between groups using a generalised linear mixed-model of repeated measures, with pre-treatment baseline values as a covariate., Neuropathic pain symptoms: NPSI total and subscores for active and placebo groups will be compared to baseline and between groups using a generalised linear mixed-model of repeated measures, with pre-treatment baseline values as a covariate.

Source: https://euclinicaltrials.eu/ctis-public/view/2022-500727-68-01